EU clinical trial 2023-507668-38-00: Biomarkers of the locus coeruleus nucleus: links with early tau pathology, cognition and AD risk. LocusTau
Protocol code: RC31/23-0371
Sponsor: Centre Hospitalier Universitaire De Toulouse (Hospital/Clinic/Other health care facility). Phase: Therapeutic exploratory (Phase II). Countries: France (ongoing, recruiting).
Therapeutic area(s): Diseases [C] - Nervous System Diseases [C10]
Gender: Female, Male. Age: 18-64 years, 65+ years. Enrolment: 100.
Status: Ongoing, recruiting. Start date (EU): 2026-02-02. Decision date: 2024-11-08. Results received: No. Last updated: 2026-06-15.

Condition(s): Alzheimer’s Disease
Product: 18F-Flortaucipir

Primary endpoint: diagnostic capabilities (sensitivity, specificity and AUC) of oculometry (pupillary response, number, latency and amplitude of ocular saccades), functional MRI (LC-hippocampus and LC-prefrontal cortex) and structural MRI (LC intensity) for a positive PET-Tau exam.
Endpoint(s): The diagnostic capabilities (sensitivity, specificity and AUC) of each of the elements of oculometry (pupillary response, number, latency and amplitude of ocular saccades), functional MRI (LC-hippocampus and LC-prefrontal cortex) and structural MRI (LC intensity) for a positive PET-Tau examination will be evaluated separately for the APOe4- and APOe4+ groups, The relationship between different LC biomarkers (PET, MRI, pupillometry)., The reliability of pupillometry and oculometry measurements will be validated by retesting a subgroup of 30 participants 1 to 4 weeks apart., The link between PET Tau uptake and changes at 12 and 24 months in pupillometry, oculometry and the structural (neuromelanin) and functional integrity of the LC measured on MRI will be assessed by correlating variations expressed as absolute values or as a proportion of the baseline value with PET Tau, and by regression., The link between variations in pupillometry, oculometry and the structural (neuromelanin) and functional integrity of the LC measured on MRI at 12 and 24 months will be evaluated by correlation between variations expressed as absolute values or as a proportion of the baseline value and by regression, The relationship between the various LC biomarkers (PET, MRI, pupillometry) and participants' cognitive performance will be assessed both at inclusion and at 12 and 24 months, using regressions that take into account age, gender, level of education and APOe4 status., All items will be compared between APOe4+ and APOe4- groups.a) Structural (neuromelanin) and functional integrity of the LC measured by MRI. b) Cognitive performance. c) Pupillometry and oculometry. d) And their evolution at 12 and 24 months.

Source: https://euclinicaltrials.eu/ctis-public/view/2023-507668-38-00